EU clinical trial 2023-505067-36-00: Clinical trial of MK-1484 given alone and with pembrolizumab in adults with solid tumors
Protocol code: MK-1484-001
Sponsor: Merck Sharp & Dohme LLC (Pharmaceutical company). Phase: Human Pharmacology (Phase I)- First administration to humans. Countries: Netherlands (ongoing, recruitment ended).
Therapeutic area(s): Diseases [C] - Neoplasms [C04]
Gender: Female, Male. Age: 18-64 years, 65+ years. Enrolment: 30.
Status: Ongoing, recruitment ended. Start date (EU): 2022-06-22. Decision date: 2023-07-28. Results received: No. Last updated: 2025-12-10.

Condition(s): Advanced or Metastatic Solid Tumors

Source: https://euclinicaltrials.eu/ctis-public/view/2023-505067-36-00